EU clinical trial 2023-510213-25-01: Beta-Blockers in Takotsubo Syndrome: A Randomized Clinical Trial
Protocol code: β-TAKO
Sponsor: Fundacion Casa Del Corazon (Educational Institution). Phase: Therapeutic use (Phase IV). Countries: Spain (ongoing, recruiting).
Therapeutic area(s): Diseases [C] - Cardiovascular Diseases [C14]
Gender: Female, Male. Age: 18-64 years, 65+ years. Enrolment: 200.
Status: Ongoing, recruiting. Start date (EU): 2024-07-08. Decision date: 2024-03-25. Results received: No. Last updated: 2025-03-28.

Condition(s): Takotsubo Syndrome (TT) is an acute cardiac condition

Primary endpoint: Comparison of left ventricular systolic function recovery as assessed by the echocardiographic left ventricular wall motion score index (WMSI) at 7 days.
Endpoint(s): A) Changes in left ventricular function by other methods (LVEF and GLS). B) Comparison of clinical outcomes (adverse clinical events).

Source: https://euclinicaltrials.eu/ctis-public/view/2023-510213-25-01